EU clinical trial 2025-522951-24-00: A Phase 2, Multi-center, Randomized, Double-blind, Placebo-controlled, Dose-ranging Study to Evaluate the Safety and Efficacy of AGA2115 in Adults with Type I, III, or IV Osteogenesis Imperfecta (OI)
Protocol code: ACT24-001
Sponsor: Angitia Inc. Ltd. (Pharmaceutical company). Phase: Therapeutic exploratory (Phase II). Countries: Netherlands (authorised, recruitment pending), France (authorised, recruitment pending), Denmark (authorised, recruitment pending).
Therapeutic area(s): Diseases [C] - Musculoskeletal Diseases [C05]
Gender: Female, Male. Age: 18-64 years, 65+ years. Enrolment: 40.
Status: Authorised, recruitment pending. Decision date: 2026-06-22. Results received: No. Last updated: 2026-07-31.
Decision dates by country: DK: 2026-06-22, FR: 2026-06-26, NL: 2026-06-24

Condition(s): Osteogenesis Imperfecta
Product: Placebo to match AGA2115, AGA2115

Primary endpoint: Percent change from Baseline at Month 12 in lumbar spine BMD

Source: https://euclinicaltrials.eu/ctis-public/view/2025-522951-24-00